EU clinical trial 2022-500808-21-00: Molecular PD-L1 PET/CT Imaging with 89Zr-atezolizumab to Monitor Immune Responses in metastatic Triple Negative Breast Cancer
Protocol code: MIMIR-mTNBC
Sponsor: Karolinska University Hospital (Hospital/Clinic/Other health care facility). Phase: Therapeutic exploratory (Phase II). Countries: Sweden (ended).
Therapeutic area(s): Diseases [C] - Neoplasms [C04]
Gender: Female, Male. Age: 18-64 years, 65+ years. Enrolment: 64.
Status: Ended. Start date (EU): 2023-02-01. End date (EU): 2024-12-23. Decision date: 2022-12-05. Results received: No. Last updated: 2022-12-05.

Condition(s): Metastatic triple negative breast cancer
Product: Tecentriq 840 mg concentrate for solution for infusion, (89Zr)Zr-Atezolizumab, CARBOPLATIN, Abraxane 5 mg/ml powder for dispersion for infusion.

Primary endpoint: Level of statistical agreement by means of Cohen’s kappa coefficient between PD-L1 IHC (positive defined as expression ≥1% on immune cells with SP142) and PD-L1 PET/CT (PD-L1 positivity is defined as having at least one lesion with radiotracer uptake over the background uptake).
Endpoint(s): Progression free survival, disease response rate and treatment discontinuation rates in three patient groups: 1. IHC positive and PET positive; 2. IHC positive and PET negative; 3. IHC negative and PET positive., Discordance in 89Zr-atezolizumab between different sites and within metastatic sites in the body., Progression free survival, disease response rate and treatment discontinuation rates in patients with ER-low mBC treated with nab-paclitaxel, carboplatin and atezolizumab., Percentage of 89Zr-atezolizumab uptake in sites, not previously determined on the routine radiological investigation with CT, as a measure of cancer spread determined on whole body 89Zr-atezolizumab PET/CT in and different metastases.

Source: https://euclinicaltrials.eu/ctis-public/view/2022-500808-21-00